EU clinical trial 2024-511099-34-00: A Modular Phase I/II Open-label Dose Escalation and Dose Expansion Study to Evaluate the Safety, Pharmacokinetics, Pharmacodynamics, and Efficacy of AZD5492, a T cell-engaging Antibody Targeting CD20 in Subjects with Relapsed or Refractory B-Cell Malignancies (TITANium)
Protocol code: TITANium
Sponsor: AstraZeneca AB (Pharmaceutical company). Phase: Human Pharmacology (Phase I)- First administration to humans. Countries: Spain (ongoing, recruiting), Germany (ongoing, recruiting), Denmark (ongoing, recruiting), Italy (ongoing, recruiting), France (ongoing, recruiting).
Therapeutic area(s): Diseases [C] - Hemic and Lymphatic Diseases [C15]
Gender: Female, Male. Age: 18-64 years, 65+ years. Enrolment: 66.
Status: Ongoing, recruiting. Start date (EU): 2024-12-12. Decision date: 2024-10-25. Results received: No. Last updated: 2026-05-13.
Decision dates by country: ES: 2024-10-25, DK: 2024-10-27, IT: 2024-10-29, FR: 2025-01-10, DE: 2024-10-29

Condition(s): B-Cell Malignancies
Product: AZD5492

Primary endpoint: Occurrence of Dose-Limiting Toxicities (DLTs), Incidence and severity of AEs, AESIs, and SAEs, SAEs/AEs leading to discontinuation of AZD5492, Clinically significant alterations in vital signs and abnormal laboratory parameters
Endpoint(s): Evaluate the preliminary antitumor activity of AZD5492 in participants with R/R B-cell malignancies, by looking at: - ORR (Overall Response Rate), CR Rate, DoR (duration of response), and PFS (progression free survival) according to Lugano criteria and iwCLL 2018 criteria; - OS (overall survival)., Characterize pharmacokinetics profile of AZD5492, by: - Determining PK parameters, including but not limited to Cmax (maximum observed concentration), AUC (Area under the curve), clearance and t½ (half-life). - Antibody serum concentration., Determine the immunogenicity of AZD5492: the number and percentage of participants who develop ADA (Anti Drug Antibodies).

Source: https://euclinicaltrials.eu/ctis-public/view/2024-511099-34-00